EU clinical trial 2024-516202-39-00: Biomarker discovery randomized phase IIb trial with carboplatin-cyclophosphamide versus paclitaxel with or without atezolizumab as first-line treatment in advanced triple negative breast cancer
Protocol code: BOOG 2013-01
Sponsor: BOOG Study Center B.V. (Laboratory/Research/Testing facility). Phase: Therapeutic exploratory (Phase II). Countries: Netherlands (ongoing, recruitment ended).
Therapeutic area(s): Diseases [C] - Neoplasms [C04]
Gender: Female, Male. Age: 18-64 years, 65+ years. Enrolment: 306.
Status: Ongoing, recruitment ended. Start date (EU): 2013-10-10. Decision date: 2024-11-22. Results received: No. Last updated: 2024-11-22.

Condition(s): Metastatic breast cancer
Product: Avastin 25 mg/ml concentrate for solution for infusion., CARBOPLATIN, PACLITAXEL, Tecentriq 840 mg concentrate for solution for infusion, Tecentriq 1 200 mg concentrate for solution for infusion, CYCLOPHOSPHAMIDE, Avastin 25 mg/ml concentrate for solution for infusion.

Primary endpoint: Interaction test of BRCA1-like status vs. treatment (CC vs. paclitaxel (both arms with or without atezolizumab or bevacizumab (patients before amendment 3)) and PFS according to RECIST v1.1 definitions for measurable and non-measurable disease 1-3.
Endpoint(s): Evaluate whether the addition of atezolizumab to paclitaxel is more favorable than adding atezolizumab to carboplatin-cyclophosphamide for patients with PD-L1 positive tumors defined as CPS 10 or higher (PFS1), Evaluate whether the addition of atezolizumab to paclitaxel is more favorable than adding atezolizumab to carboplatin-cyclophosphamide (PFS1), Test the benefit of the addition of atezolizumab to chemotherapy using objective response rate (ORR), proportion of patients free of progression at 6 months and at 12 months, all according to RECIST v1.1 definitions (see also appendix F) 1-3., Overall- survival (OS) benefit of the addition of atezolizumab versus no atezolizumab to first line palliative chemotherapy. OS is measured from the day of randomization to the occurrence of death of any cause., Determine PFS and OS regarding the efficacy of the two different first line chemotherapeutic regimens, regardless of antibody add-on yes or no, in the whole study group, and in the BRCA1-like and non-BRCA1-like TNBC subgroups separately., Evaluate whether a PFS/ORR/OS difference exists between efficacy of atezolizumab added to chemotherapy in BRCA1-like TNBC and in non-BRCA1-like TNBC, regardless of chemotherapy regimen, Evaluate whether a PFS/ORR/OS difference exists between efficacy of atezolizumab added to chemotherapy in BRCA1-like TNBC and non-BRCA1-like TNBC, stratified by chemotherapy regimen, Evaluate whether an alkylating-platinum regimen is more effective than paclitaxel as first line chemotherapy regarding PFS/OS in BRCA1-like TNBC, Evaluate whether paclitaxel is more effective than an alkylating regimen as first line chemotherapy regarding PFS/OS in non-BRCA1-like TNBC, Define whether PD-L1 status predicts for benefit of atezolizumab added to first line palliative chemotherapy in TNBC; test association between PD-L1 status and ORR, proportion of patients free of progression at 6 months and at 12 months stratified by chemotherapy regimen, Define whether tumor intratumoral CD8 and tumor infiltrating lymphocytes (TIL) predicts for benefit of atezolizumab added to first line palliative chemotherapy in TNBC; test the association between intratumoral CD8 (cut off to be determined) and ORR, proportion of patients free at progression at 6 and 12 months stratified by chemotherapy regimen., Determine whether certain molecular TNBC subtypes (based on RNA-expression analysis) are predictive for benefit of atezolizumab to first line chemotherapy using ORR, proportion of patients free of progression at 6 months and at 12 months, Discovery of predictive biomarkers for benefit of atezolizumab added to first line palliative chemotherapy in TNBC using ORR, proportion of patients free of progression at 6 months and at 12 months, To define whether pretreatment LDH level (cut off to be determined) predicts for benefit of atezolizumab added to first line palliative chemotherapy in TNBC using ORR, proportion of patients free of progression at 6 months and at 12 months, Exploratory analysis to define biomarkers that can predict for a PFS/OS advantage of carboplatin-cyclophosphamide as first line palliative chemotherapy in TNBC, Exploratory analysis to define biomarkers that can predict for a PFS/OS advantage of paclitaxel as first line palliative chemotherapy in TNBC, Evaluation of progression free survival (PFS2)/ORR and proportion of patients free of progression at 6 months and 12 months after cross-over to the other chemotherapy regimen with atezolizumab, Evaluate whether addition of atezolizumab to chemotherapy in first line is more beneficial than when added in second line, Clinically relevant toxicity of all study regimens according to NCI CTCAE v4.03

Source: https://euclinicaltrials.eu/ctis-public/view/2024-516202-39-00